EU clinical trial 2024-511826-29-00: Evaluation of irritation potential of topical formulations on intact skin
Protocol code: LT_EUR_MOME/2023
Sponsor: Grindeks AS (Pharmaceutical company). Phase: Human Pharmacology (Phase I)- Other. Countries: Germany (ended).
Therapeutic area(s): Phenomena and Processes [G] - Cell Physiological Phenomena [G04]; Phenomena and Processes [G] - Physiological processes [G07]
Gender: Female, Male. Age: 18-64 years, 65+ years. Enrolment: 33.
Status: Ended. Start date (EU): 2024-06-20. End date (EU): 2024-07-22. Decision date: 2024-06-07. Results received: No. Last updated: 2024-06-07.

Condition(s): Dermal tolerability test: Testing for non-specific, local irritating reactions on intact skin using mean cumulative irritation score (CIS).

Source: https://euclinicaltrials.eu/ctis-public/view/2024-511826-29-00